EU clinical trial 2024-519797-39-00: Aminoglycosides in early sepsis (AGES): A randomized pragmatic clinical trial comparing gentamicin and narrow spectrum betalactams to broad spectrum betalactams as empirical treatment in patients with suspected sepsis
Sponsor: Akershus University Hospital (Hospital/Clinic/Other health care facility). Phase: Therapeutic use (Phase IV). Countries: Norway (ongoing, recruiting).
Therapeutic area(s): Diseases [C] - Bacterial Infections and Mycoses [C01]
Gender: Female, Male. Age: 18-64 years, 65+ years. Enrolment: 2000.
Status: Ongoing, recruiting. Start date (EU): 2025-07-01. Decision date: 2025-07-01. Results received: No. Last updated: 2026-06-30.

Condition(s): Sepsis
Product: CEFOTAXIME, CLOXACILLIN, GENTAMICIN, AMPICILLIN, BENZYLPENICILLIN, PIPERACILLIN AND BETA-LACTAMASE INHIBITOR

Primary endpoint: Death up to 30 days after randomization, Any acute kidney injury up to 30 days after randomization
Endpoint(s): In-hospital mortality, Mortality up to 30 days after discharge, Duration of hospital stay, Duration of intensive care stay, Duration of ventilator therapy, Duration of vasopressor therapy, Hospital readmissions up to 30 days after discharge, Duration of antibiotic treatment

Source: https://euclinicaltrials.eu/ctis-public/view/2024-519797-39-00